EU clinical trial 2023-505453-40-00: 99mTechnetium and Cyanine-5 (HybriD) Prostate Specific Membrane Antigen (PSMA) Tracer-gUided Surgery in ProstAte Cancer - a FeasibiLity Study (DUAL study)
Sponsor: Het Nederlands Kanker Instituut-Antoni van Leeuwenhoek Ziekenhuis Stichting (Hospital/Clinic/Other health care facility). Phase: Phase I and Phase II (Integrated)- First administration to humans. Countries: Netherlands (authorised, recruitment pending).
Therapeutic area(s): Diseases [C] - Male Urogenital Diseases [C12]; Diseases [C] - Neoplasms [C04]
Gender: Male. Age: 18-64 years, 65+ years. Enrolment: 13.
Status: Authorised, recruitment pending. Decision date: 2025-07-11. Results received: No. Last updated: 2025-07-11.

Condition(s): Prostate cancer
Product: hybrid PSMA

Primary endpoint: The presence of lesion-specific uptake of 99mTc-hPSMA by PCa
Endpoint(s): Assessment of adverse events according to CTCv5 for 14 days post-injection, Tracer distribution at 1h post-injection (in first 5 patients, group A), Tracer distribution at 15h post-injection (group A+B in all 13 patients), Intra-operative mapping of prostatic tumor focus-ing 99mTc-hPSMA, The sensitivity (true positive rate) and specificity (true negative rate) of positive surgical margins (PSMs) identification respective to histopathological analysis, Registration of radioactive and fluorescent signal intensities in background and tumor tissue, The concordance rate between areas identified as positive on preoperative PSMA-PET/CT and those visible on preoperative PSMA-SPECT/CT, The number and location of lymph nodes were identified intra-operatively with 99mTc-hPSMA compared to preoperative PSMA-PET/CT and PSMA SPECT/CT findings, The sensitivity (true positive rate) and specificity (true negative rate) of 99mTc-hPSMA in detecting nodal metastases respective to histopathological analysis, PSA measurement at first postoperative visit (approxi-mately 3-6 months post-operative), The measured signal-to-background ratio (SBR) of the fluorescent and radioactive signals in both in vivo and ex vivo tissues, The assessment of surgeons' dexterity during RALP, measured by the movements of the drop-in gamma probe

Source: https://euclinicaltrials.eu/ctis-public/view/2023-505453-40-00